EU clinical trial 2024-516039-28-00: Randomized clinical trial assessing the value of Beta-Blockers and Antiplatelet Agents in patients with Spontaneous Coronary Artery Dissection (BA-SCAD).
Protocol code: BA-SCAD
Sponsor: Spanish Society Of Cardiology (Laboratory/Research/Testing facility). Phase: Therapeutic use (Phase IV). Countries: Spain (ongoing, recruitment ended).
Therapeutic area(s): Diseases [C] - Cardiovascular Diseases [C14]
Gender: Female, Male. Age: 18-64 years, 65+ years. Enrolment: 700.
Status: Ongoing, recruitment ended. Start date (EU): 2021-09-28. Decision date: 2024-07-16. Results received: No. Last updated: 2024-07-16.

Condition(s): Spontaneous Coronary Artery Dissection.
Product: ACETYLSALICYLIC ACID, PRASUGREL, METOPROLOL, PROPRANOLOL, ATENOLOL, CARVEDILOL, CLOPIDOGREL, BISOPROLOL, TICAGRELOR

Primary endpoint: A combined clinical endpoint including death, MI, stroke, coronary revascularization, recurrent dissection and hospital admission for ACS or heart failure at 1-year follow-up.
Endpoint(s): a secondary combined clinical endpoint (composite of death, MI, stroke, coronary revascularization, and recurrent dissection, hospital admission for ACS –with dynamic ECG changes- or heart failure or bleeding) will be used to assess the “net clinical benefit” of the antiplatelet strategy., Bleeding will be also analyzed as a separate safety secondary endpoint. Bleeding will be defined according to BARC definitions., Individual components of the primary endpoint will be assessed as secondary endpoints. Besides, a major predefined secondary combined endpoint will be the composite outcome measure of “hard” clinical events (including death, MI, stroke, recurrent dissection and coronary revascularization) and the combined outcome measure of death and MI alone.

Source: https://euclinicaltrials.eu/ctis-public/view/2024-516039-28-00